EU clinical trial 2025-522774-36-00: A Phase 1 Study of NDI-219216 in Patients with Advanced Solid Tumors with and without Microsatellite Instability and/or Deficient Mismatch Repair
Protocol code: 9216-101
Sponsor: Nimbus Wadjet Inc. (Pharmaceutical company). Phase: Human Pharmacology (Phase I)- First administration to humans. Countries: Spain (ongoing, recruiting), Portugal (ongoing, recruiting), France (ongoing, recruiting), Ireland (ongoing, recruiting).
Therapeutic area(s): Diseases [C] - Neoplasms [C04]
Gender: Female, Male. Age: 18-64 years, 65+ years. Enrolment: 54.
Status: Ongoing, recruiting. Start date (EU): 2025-10-24. Decision date: 2025-09-15. Results received: No. Last updated: 2026-03-23.
Decision dates by country: ES: 2025-09-17, PT: 2025-09-16, IE: 2025-10-17, FR: 2025-09-15

Condition(s): Advanced solid tumors

Source: https://euclinicaltrials.eu/ctis-public/view/2025-522774-36-00